EU clinical trial 2024-516740-26-00: SAKK 38/19: Assessing a ctDNA and PET-oriented therapy in patients with DLBCL. A multicenter, open-label, phase II trial
Protocol code: SAKK 38/19
Sponsor: Swiss Group for Clinical Cancer Research (Patient organisation/association). Phase: Therapeutic exploratory (Phase II). Countries: Italy (authorised, recruitment pending).
Therapeutic area(s): Diseases [C] - Neoplasms [C04]
Gender: Female, Male. Age: 18-64 years, 65+ years. Enrolment: 104.
Status: Authorised, recruitment pending. Decision date: 2024-10-14. Results received: No. Last updated: 2026-06-25.

Condition(s): Disseminated large B-cell lymphoma
Product: ACALABRUTINIB, Calquence 100 mg film-coated tablets

Primary endpoint: Cohorts A, C and D: Progression free survival (PFS) according to the Lugano criteria. PFS is defined as the time from registration until the first event of interest: • Progressive disease according to the Lugano Classification • Death from any cause, Cohort B: Complete remission (CR) rate at the end of therapy according to the Lugano criteria. Patients with CR at the end of therapy will be considered CR.
Endpoint(s): Adverse events (AEs): All AEs will be assessed according to NCI CTCAE v5.0., Overall survival (OS): OS will be calculated from registration until death from any cause. Patients not experiencing an event will be censored at the last date they were known to be alive., Progression free survival in cohort B: Analogous to the evaluation of the primary endpoint of cohorts A, C and D (see 3.2.1), but in cohort B., Complete remission rate in cohorts A, C and D: Analogous to the evaluation of the primary endpoint of cohort B (see 13.2.1), but in cohorts A, C and D., Overall response rate (ORR): Overall response rate at the end of therapy is defined as either PR or CR (OR) according to the Lugano criteria., Duration of response (DoR) The duration of response will be calculated from when the criteria for CR or PR are met, until documentation of progressive disease thereafter. Only patients with a CR or PR will be included in this analysis.

Source: https://euclinicaltrials.eu/ctis-public/view/2024-516740-26-00